EU clinical trial 2023-508828-35-01: A Phase III, multicenter, open-label study of ribociclib vs. palbociclib in patients with advanced hormone receptor-positive/HER2-negative/HER2-Enriched breast cancer - HARMONIA
Protocol code: SOLTI-2101
Sponsor: Solti Group (Laboratory/Research/Testing facility). Phase: Therapeutic confirmatory (Phase III). Countries: Spain (ended), Portugal (ended).
Therapeutic area(s): Diseases [C] - Neoplasms [C04]
Gender: Female, Male. Age: 18-64 years, 65+ years. Enrolment: 316.
Status: Ended. Start date (EU): 2022-03-28. End date (EU): 2026-02-27. Decision date: 2024-09-04. Results received: No. Last updated: 2026-03-31.
Decision dates by country: PT: 2024-10-25, ES: 2024-09-04

Condition(s): Patients with advanced hormone receptor-positive/HER2- negative/HER2-Enriched breast cancer
Product: Tevimbra 100 mg concentrate for solution for infusion, IBRANCE 125 mg hard capsules, Kisqali 200 mg film-coated tablets, IBRANCE 100 mg hard capsules, IBRANCE 75 mg hard capsules, Tevimbra 100 mg concentrate for solution for infusion, Tevimbra 100 mg concentrate for solution for infusion, Kisqali 200 mg film-coated tablets, Tevimbra 100 mg concentrate for solution for infusion

Primary endpoint: Progression-free survival using RECIST 1.1 criteria, as assessed by local radiologists/investigators
Endpoint(s): To compare the two treatment arms with respect to PFS2 in the HER2-E cohort, To compare the two treatment arms with respect to overall survival in the HER2-E cohort, To evaluate the two treatment arms with respect to ORR and clinical benefit rate (CBR) in HER2-E patients, where CBR, defined as percentage of patients with CR, PR per RECIST or SD lasting 24 weeks or longer., To evaluate the safety and tolerability of ribociclib and palbociclib in combination with endocrine therapy the HER2-E cohort, To evaluate patient reported outcomes for health-related quality of life in the two treatment arms of the HER2-E cohort., To describe time to response and duration of response in each treatment arm.

Source: https://euclinicaltrials.eu/ctis-public/view/2023-508828-35-01